EU clinical trial 2025-520976-25-00: A multicenter phase 2 study of Belantamab mafodotin and Mezigdomide in combination with a phase Ib Safety run in patients with relapsed multiple myeloma following BCMA-targeting CAR-T cells or bispecific antibodies. The IFM 2024-01 clinical trial (BELAMI)
Protocol code: 24CH294
Sponsor: Centre Hospitalier Universitaire De Saint Etienne (Hospital/Clinic/Other health care facility). Phase: Therapeutic exploratory (Phase II). Countries: France (authorised, recruitment pending).
Therapeutic area(s): Diseases [C] - Hemic and Lymphatic Diseases [C15]
Gender: Female, Male. Age: 18-64 years, 65+ years. Enrolment: 44.
Status: Authorised, recruitment pending. Decision date: 2026-04-09. Results received: No. Last updated: 2026-04-09.

Condition(s): Relapsed/refractory multiple myeloma
Product: CC-92480

Primary endpoint: Defined as the duration from the start date of treatement to the date of either progressive disease, or death, whichever occurs first. Progressive disease will be evaluated as defined by 2016 IMWG response criteria (Kumar et al. 2016), as data permits, and assessed by the investigator. If the subject is responder or the status is unknown at last contact, then the subject’s data will be censored at the date the subject was last known to be non-progressive
Endpoint(s): ORR, defined as CR or VGPR or PR, according to the IMWG criteria at the time of data cutoff, % VGPR or better, CR, VGPR, PR, PD defined according to the IMWG criteria at the time of data cutoff, Time to response measured from the start date of treatment to the date of first response according to the IMWG criteria, Response duration measured from the start date of treatment to the date of first progression according to the IMWG criteria, OS measured from the start date of treatment to the date of the subject’s death. If the subject is alive or the vital status is unknown at last contact, then the subject’s data will be censored at the date the subject was last known to be alive, TTP defined as time from the start date of treatment until objective tumor progression date, TNT defined as the time from the start date of treatement to the start of the next-line treatment, TTF, defined as time from the start date of treatement to discontinuation of therapy for any reason including death, progression, toxicity, Assessing therapy-related adverse events according to the National Cancer Institute's Common Terminology Criteria for Adverse Events (CTCAE, Version 5.0), particularly ocular events, to understand corneal safety and tolerability, Simplified OSDI (Ocular Surface Disease Index), Ocular AE management (treatment: belamaf dose and schedule modification), Investigating exploratory endpoints related to the biobank

Source: https://euclinicaltrials.eu/ctis-public/view/2025-520976-25-00